EU clinical trial 2023-510292-65-00: A Phase 3, Randomized, Double-Blind, Placebo-Controlled Study of Axatilimab (INCA034176) and Corticosteroids as Initial Treatment for Chronic Graft-Versus Host Disease (AXemplify 357)
Protocol code: INCA34176-357
Sponsor: Incyte Corp. (Pharmaceutical company). Phase: Therapeutic confirmatory (Phase III). Countries: Italy (ongoing, recruiting), Denmark (ongoing, recruiting), Spain (ongoing, recruiting), Ireland (ongoing, recruiting), France (ongoing, recruiting), Germany (ongoing, recruiting), Netherlands (ongoing, recruiting), Austria (ongoing, recruiting).
Therapeutic area(s): Diseases [C] - Immune System Diseases [C20]
Gender: Female, Male. Age: 0-17 years, 18-64 years, 65+ years. Enrolment: 201.
Status: Ongoing, recruiting. Start date (EU): 2025-02-25. Decision date: 2025-01-21. Results received: No. Last updated: 2026-05-25.
Decision dates by country: DE: 2025-01-24, FR: 2025-01-21, NL: 2025-01-27, DK: 2025-05-09, IE: 2025-01-24, AT: 2025-02-05, IT: 2025-01-21, ES: 2025-01-22

Condition(s): chronic graft-versus-host disease
Product: Placebo, Axatilimab (INCA034176), PREDNISONE, METHYLPREDNISOLONE

Primary endpoint: EFS, defined as the time from the date of randomization to the date of the first EFS event. Events are defined as addition or initiation of new systemic therapy for cGVHD, death due to any cause, or Day 1 in the case of treatment failure (non-CR or non-PR by Month 6).
Endpoint(s): OR at 6 months, defined for each treatment group as CR or PR at 6 months (C7D1) in the absence of new systemic therapy for cGVHD. Response assessment will be based on the 2014 NIH Consensus Development Project on Criteria for Clinical Trials in cGVHD (refined NIH response algorithm for cGVHD disease in joints and fascia [Inamoto et al 2020])., Response, defined as the proportion of participants with a ≥ 7-point improvement in mLSS total score at 6 months (C7D1)., EFS2, defined as the time from the date of randomization to the date of the first EFS event. Events are defined as date of progression based on best prior organ status (nadir in score level), addition or initiation of new systemic therapy for cGVHD, death due to any cause, or Day 1 in the case of treatment failure (non-CR or non-PR by Month 6).

Source: https://euclinicaltrials.eu/ctis-public/view/2023-510292-65-00